EU clinical trial 2024-514386-19-00: A phase I study of neoadjuvant treatment with 177-Lutetium-PSMA-617 with Ipilimumab in subjects with very high-risk prostate cancer who are candidates for radical prostatectomy (NEPI Trial)
Protocol code: CA184-608
Sponsor: Universitaetsklinikum Essen AöR (Hospital/Clinic/Other health care facility). Phase: Human Pharmacology (Phase I)- Other. Countries: Germany (ended).
Therapeutic area(s): Diseases [C] - Male Urogenital Diseases [C12]
Gender: Male. Age: 18-64 years, 65+ years. Enrolment: 12.
Status: Ended. Start date (EU): 2025-08-25. End date (EU): 2026-03-09. Decision date: 2024-07-31. Results received: No. Last updated: 2025-07-22.

Condition(s): Patients with very high-risk prostate cancer (as defined by a total Gleason-Score ≥4+4 [ISUP-GG 4+5] and clinical stage cT3 (digital rectal examinations or imaging based) plus clinical nodal status cN+ or Serum-PSA level > 20 ng/ml who are candidates for radical prostatectomy with pelvic lymph node dissection.
Product: Ipilimumab, Pluvicto 1 000 MBq/mL solution for injection/infusion, Ipilimumab

Primary endpoint: Feasibility will be defined as the ability to perform prostatectomy in at least 83,33 % of participants of a treatment arm 85 days after start of neoadjuvant treatment with a maximum delay by 3 weeks in the present study., Safety of neoadjuvant treatment with ipilimumab and [177Lu]Lu-PSMA-617 RLT before radical prostatectomy will be characterized according to Adverse Events and Serious Adverse Events measured using National Cancer Institute Common Terminology Criteria for Adverse Events (NCI CTCAE) v5.0.
Endpoint(s): Clinical activity is measured by pathologic complete response (pCR) and minimal residual disease (MRD), which is defined as a tumor burden of 5 mm or less in the largest dimensions., Disease-free survival measurements are also performed. Disease-free survival is defined as PSA progression-free survival up to 1 year after prostatectomy.

Source: https://euclinicaltrials.eu/ctis-public/view/2024-514386-19-00